EU clinical trial 2024-515140-23-00: AliCsa; Efficacy of oral alitretinoin versus oral cyclosporine in patients with moderate to very severe hand eczema. A randomized prospective open-label trial with blinded outcome assessment
Protocol code: 54659
Sponsor: Universitair Medisch Centrum Groningen (Hospital/Clinic/Other health care facility). Phase: Therapeutic use (Phase IV). Countries: Netherlands (authorised, recruitment pending).
Therapeutic area(s): Diseases [C] - Skin and Connective Tissue Diseases [C17]
Gender: Female, Male. Age: 18-64 years, 65+ years. Enrolment: 78.
Status: Authorised, recruitment pending. Decision date: 2024-11-08. Results received: No. Last updated: 2024-11-08.

Condition(s): Hand eczema
Product: ALITRETINOIN, CICLOSPORIN, ALITRETINOIN, CICLOSPORIN

Primary endpoint: In this study the main endpoint is the between-group difference in response to treatment between baseline and 24 weeks of treatment.
Endpoint(s): Between-group difference in reaching an improvement of ≥ 2 steps on the PGA score, based on a validated Photographic Guide developed by Coenraads et al (16) at 24 weeks of treatment., Between-group difference in response to treatment between baseline and 12 weeks of treatment., Between-group difference in mean change between baseline and week 4, 8, 12 and 24, assessed by the Hand Eczema Severity Index (HECSI) score.(23) The HECSI is an objective severity assessment based on clinical symptoms only. It includes erythema, fissures, vesicles, scaling, oedema, papules and measurement of the affected area. The score ranges from 0-360, with a score > 28 indicating severe hand eczema., Between-group difference in time to response (achieving ‘clear’/’almost clear’ in the PGA score). This is only measured at control visits so possible outcome is limited to 4, 8, 12 and 24 weeks. This will be corrected using statistical methods (see paragraph 10.2)., Between-group mean change in quality of life between baseline and 12 and 24 weeks, assessed by the Quality Of Life in Hand Eczema Questionnaire (QOLHEQ). The QOLHEQ is a multi domain disease specific instrument for hand eczema assessing impairments in quality of life. The score ranges from 0-120, with 120 indicating worst quality of life., Between-group difference in patients reporting improvement as ‘clear or almost clear’ at week 12 and 24, assessed by Patient Global Assessment (PaGA). The PaGA takes signs and symptoms into account. It covers 6 degrees of improvement: ‘clear or almost clear’ (at least 90% clearing of disease signs and symptoms compared to baseline), ‘marked improvement’ (at least 75% clearing), ‘moderate improvement’ (at least 50% clearing), ‘mild improvement’ (at least 25% clearing), ‘no change’, or ‘worsening’, Safety and tolerability • Adverse events in both groups will be registered, Between-group difference in mean Quality Adjusted Life Years (QALY’s) measured by the EQ-5D-5L score at baseline, week 12 and week 24. The EQ-5D-5L is a measure for HRQoL and utility values. The EQ-5D-5L questionnaire includes a descriptive system, which comprises 5 dimensions of health: mobility, self-care, usual activities, pain/discomfort, and anxiety/depression. Moreover it includes a visual analog scale (VAS),that records the respondent's self-rated health status on graduated (0–100) scale, Direct medical costs will be calculated using standardized prices for consultations, treatments (alitretinoin, cyclosporine, corticosteroids, emollients, antibiotics), diagnostic tests, lab measurements, GP visits for hand eczema, and hospital admissions (inpatient/daycare). Patients will track out-of-pocket expenses for OTC medications and other hand eczema products. Direct non-medical costs, like travel expenses, will follow average travel costs to the hospital as per Dutch healthcare guidelin, Indirect costs, consisting mainly of productivity loss, will be also be calculated using tables from the guidelines with average income of Dutch workers stratified by age and gender, corrected for shift working / irregular working hours.

Source: https://euclinicaltrials.eu/ctis-public/view/2024-515140-23-00